EU clinical trial 2025-522279-27-00: A Phase 3, Randomized, Double-Blind, Placebo-Controlled Study of Revumenib in Combination with Intensive Chemotherapy in Participants with Newly Diagnosed AML with an NPM1 mutation (REVEAL-ND NPM1)
Protocol code: SNDX-5613-0710
Sponsor: Syndax Pharmaceuticals Inc. (Pharmaceutical company). Phase: Therapeutic confirmatory (Phase III). Countries: Greece (ongoing, recruiting), Poland (authorised, recruitment pending), Spain (ongoing, recruiting), Austria (ongoing, recruiting), Italy (ongoing, recruiting), Romania (ongoing, recruiting), Belgium (authorised, recruiting), France (authorised, recruiting), Lithuania (authorised, recruitment pending), Germany (authorised, recruiting), Hungary (authorised, recruiting), Czechia (authorised, recruitment pending), Portugal (authorised, recruitment pending).
Therapeutic area(s): Diseases [C] - Neoplasms [C04]
Gender: Female, Male. Age: 0-17 years, 18-64 years, 65+ years. Enrolment: 343.
Start date (EU): 2026-04-02. Decision date: 2026-02-13. Results received: No. Last updated: 2026-06-22.
Decision dates by country: AT: 2026-02-16, BE: 2026-02-16, CZ: 2026-02-16, DE: 2026-02-17, ES: 2026-02-23, FR: 2026-02-16, GR: 2026-02-16, HU: 2026-02-23, IT: 2026-02-17, LT: 2026-02-13, PL: 2026-02-22, RO: 2026-02-23, PT: 2026-05-14

Condition(s): Newly Diagnosed AML with an NPM1 mutation
Product: Revumenib, Revumenib, Placebo for Revumenib tablets, CYTARABINE, IDARUBICIN HYDROCHLORIDE, DAUNORUBICIN HYDROCHLORIDE, Revumenib

Primary endpoint: EFS: Defined as the time from the date of randomization to the date of Induction treatment failure, relapse or death due to any cause, whichever occurs first. MRDBM (-) CR rate: Defined as the percentage of participants with CR
Endpoint(s): OS: Defined as the time from the date of randomization to the date of death from any cause., EFS (Investigator-assessed): Defined as the time from the date of randomization to the date of Induction treatment failure, relapse or death due to any cause, whichever occurs first., MRDBM (-) CR rate: Defined as the percentage of participants with CR (Investigator-assessed) who achieve MRDBM (-) status by molecular assay, MRDPB (-) CR rate: Defined as the percent of participants with CR (Investigator assessed) who achieve MRDPB (-) status by molecular assay, MRDBM (-) CR rate: Defined as the percent of participants with CR who achieve MRDBM (-) status., CR rate (Investigator-assessed): Defined as the percentage of participants who achieve CR, CRc rate (Investigator-assessed): Defined as the rate of CR + CRh (complete remission with partial hematologic recovery) + Cri (complete remission with incomplete hematologic recovery)., ORR (Investigator-assessed): Defined as the rate of CR + CRh + CRi + MLFS (morphologic leukemia-free state) + PR (partial response)., Duration of CR: Defined as time from first date of first CR to relapse or death., Duration of CRc: Defined as time from first date of first CRc to relapse or death., DOR: Defined as time from date of first documented response (CR, CRh, CRi, PR, or MLFS) to the first documented relapse or death., • Frequency, duration, and severity of TEAEs (treatment-emergent adverse events), TRAEs (treatment-related adverse event), and SAEs. • Incidence and shifts from baseline of clinically significant clinical laboratory abnormalities. • Change from baseline in other observations related to safety, including ECGs, vital signs, and performance status.

Source: https://euclinicaltrials.eu/ctis-public/view/2025-522279-27-00